EU clinical trial 2023-503915-14-00: ARGX-113-2211: Open-Label Extension Study to Evaluate the Safety of Efgartigimod in Adult Patients with primary Sjögren’s Syndrome (pSS) who complete qualifying efgartigimod pSS studies
Protocol code: ARGX-113-2211
Sponsor: Argenx (Pharmaceutical company). Phase: Therapeutic exploratory (Phase II). Countries: Poland (ended), Hungary (ended), Belgium (ended).
Therapeutic area(s): Phenomena and Processes [G] - Immune system processes [G12]
Gender: Female, Male. Age: 18-64 years. Enrolment: 27.
Status: Ended. Start date (EU): 2023-11-15. End date (EU): 2025-02-03. Decision date: 2023-09-25. Results received: Yes. Last updated: 2025-01-13.
Decision dates by country: HU: 2023-09-28, PL: 2023-09-29, BE: 2023-09-25

Condition(s): Primary Sjögren's Syndrome
Product: ARGX-113

Primary endpoint: Incidence and severity of AEs and AESIs, incidence SAEs, changes in laboratory test results, vital signs, and ECG results
Endpoint(s): Proportion of CRESS responders on ≥ 3 of 5 items at weeks 24 and 48, Proportion of participants with minimal clinically important improvement from baseline in ESSDAI: improvement of ≥ 3 points in ESSDAI score at weeks 24 and 48, Proportion of participants with low disease activity: ESSDAI score of < 5 at weeks 24 and 48, Proportion of participants with minimal clinically important improvement from baseline in clinESSDAI: improvement of ≥ 3 points in clinESSDAI score at weeks 24 and 48, Proportion of participants with low disease activity: clinESSDAI score of < 5 at weeks 24 and 48, Proportion of participants with minimal clinically important improvement from baseline in ESSPRI: decrease of ≥ 1 point or ≥ 15% at weeks 24 and 48, Change from baseline in ESSDAI score at weeks 24 and 48, Change from baseline in clinESSDAI score at weeks 24 and 48, Change from baseline in ESSPRI score at weeks 24 and 48, Proportion of STAR responders (score of ≥ 5) at weeks 24 and 48 when compared to baseline, Values, changes from baseline, and percent reduction from baseline in total IgG levels in serum over the 48 week treatment period, Values, changes from baseline, and percent reduction from baseline in autoantibodies in serum over the 48-week treatment period: Anti-Ro/SS A; Anti-La/SS B, Efgartigimod serum concentrations over the 48-week treatment period, Incidence and prevalence of ADA against efgartigimod over the 48-week treatment period

Source: https://euclinicaltrials.eu/ctis-public/view/2023-503915-14-00